EU clinical trial 2022-500287-35-00: Study of tuvusertib (M1774) in combination with DNA Damage Response Inhibitors or Immune Checkpoint Inhibitors
Protocol code: MS201924_0020
Sponsor: Merck Healthcare KGaA (Pharmaceutical company). Phase: Human Pharmacology (Phase I)- Other. Countries: Spain (ended).
Therapeutic area(s): Diseases [C] - Neoplasms [C04]
Gender: Female, Male. Age: 18-64 years, 65+ years. Enrolment: 33.
Status: Ended. Start date (EU): 2022-09-21. End date (EU): 2026-02-05. End date: 2026-07-20. Decision date: 2022-09-01. Results received: No. Last updated: 2026-01-23.

Condition(s): Metastatic or Locally Advanced Unresectable Solid Tumors

Source: https://euclinicaltrials.eu/ctis-public/view/2022-500287-35-00